EU clinical trial 2024-515467-66-00: Phase 2 study of the infusion of differentiated autologous T-cells from peripheral blood, expanded and transduced with a lentivirus to express a chimeric antigen receptor with anti-CD19 specificity (A3B1) conjugated with the co-stimulatory regions 4-1BB and CD3z (ARI-0001 cells) in children and adolescents aged 0-18 years with CD19+ acute lymphoblastic leukaemia resistant or refractory to treatment.
Protocol code: CART19-BE-03Ped
Sponsor: Fundacio Sant Joan De Deu (Patient organisation/association). Phase: Therapeutic exploratory (Phase II). Countries: Spain (ongoing, recruitment ended).
Therapeutic area(s): Diseases [C] - Neoplasms [C04]
Gender: Female, Male. Age: 0-17 years. Enrolment: 33.
Status: Ongoing, recruitment ended. Start date (EU): 2024-07-22. Decision date: 2024-07-22. Results received: No. Last updated: 2026-01-16.

Condition(s): Acute lymphoblastic leukemia
Product: ETOPOSIDE, METHYLPREDNISOLONE, CYTARABINE, DEXCHLORPHENIRAMINE MALEATE, PARACETAMOL, CYCLOPHOSPHAMIDE, ALLOPURINOL, TOCILIZUMAB, HUMAN IMMUNOGLOBULIN G, Varnimcabtagene autoleucel, FLUDARABINE

Primary endpoint: Complete response rate (complete remission [CR] rate plus CR rate with incomplete haematological recovery [CRi]), with undetectable measurable residual disease by multiparameter flow cytometry within day +100 after the infusion of ARI-0001 cells. In patients with isolated extramedullary disease, response evaluation will be done through morphology and flow cytometry of the cerebrospinal fluid (CSF) and/or imaging tests (PET-CT or MRI)
Endpoint(s): Key secondary endpoint: Event-free survival (EFS) at month 12, Duration of remission: defined as the time from achievement of CR or CRi (whichever occurs first) to relapse or death due to ALL, Relapse free survival (RFS) at 12 months, Overall survival at 12 months, Transplant and disease-free survival at 6 and 12 months, In vivo survival of ARI-0001 cells in peripheral blood as determined by flow cytometry and by qPCR of the transgene weekly the first month, monthly in the first 6 months and then at 12 months., B-cell aplasia, measured by flow cytometry, weekly the first month, monthly in the first 6 months, every 3 months from month 6 to month 12 and every 6 months until end of study, Toxicity, defined as adverse events of grade ≥3 according to common toxicity criteria (version 5.0). Adverse events of significant interest will be CRS, ICANS and cerebral ooedema, which will be graded according to the ASTCT classification (1). Procedure-related mortality will also be measured.

Source: https://euclinicaltrials.eu/ctis-public/view/2024-515467-66-00